EU clinical trial 2024-515275-35-00: Evaluating the Therapeutic Efficacy of Filgrastim in Severe Bullous Drug Eruptions (Lyell and Stevens-Johnson Syndromes)
Sponsor: Hospices Civils De Lyon (Hospital/Clinic/Other health care facility). Phase: Phase II and Phase III (Integrated). Countries: France (ongoing, recruiting).
Therapeutic area(s): Diseases [C] - Skin and Connective Tissue Diseases [C17]
Gender: Female, Male. Age: 0-17 years, 18-64 years, 65+ years. Enrolment: 42.
Status: Ongoing, recruiting. Start date (EU): 2022-05-13. Decision date: 2024-08-12. Results received: No. Last updated: 2025-06-27.

Condition(s): Lyell syndrome, Stevens Johnson syndrome
Product: Zarzio 48 MU/0.5 ml solution for injection or infusion in pre-filled syringe, GLUCOSE FRESENIUS 5 %, solution pour perfusion, Zarzio 30 MU/0.5 ml solution for injection or infusion in pre-filled syringe

Primary endpoint: Comparison between the 2 groups of the proportion of patients with a halt in the progression of skin detachment at D5 (D0: initiation of treatment) defined by a detached and/or bullous surface and/or associated with a NIKOLSKY sign determined according to the stable burns table
Endpoint(s): Time to stop progression, Time to complete re-epidermalization, defined as disappearance of skin erosions AND return to normal skin, Overall survival at D30, Overall survival to D365, Number of hospital days corresponding to the length of hospitalization for the SJS/NET episode, Number per patient and nature of clinical or biological adverse events observed between D0 and D5 leading to premature discontinuation of filgrastim treatment, Total number per patient and nature of clinical or biological adverse events observed up to D365, Use of systemic corticosteroid therapy between D0 and D15, with a study of the nature, cumulative doses and indications for objective prescriptions. A comparison will be made between the 2 treatment groups., Presence of ophthalmological, stomatological/ORL, gastroenterological, gynecological, urological and psychiatric sequelae, Patient quality of life, Risk of developing post-traumatic stress disorder (PTSD)

Source: https://euclinicaltrials.eu/ctis-public/view/2024-515275-35-00